EU clinical trial 2024-519667-18-00: Preventing postoperative complications in patients undergoing high-risk pancreatoduodenectomy with a bundle approach including hydrocortisone, ocreotide, and teres ligament patch (PANENCA): an international randomized controlled multicenter trial
Protocol code: 1.1
Sponsor: Amsterdam UMC Stichting (Patient organisation/association). Phase: Therapeutic use (Phase IV). Countries: Netherlands (ongoing, recruiting), Finland (ongoing, recruiting), Sweden (ongoing, recruiting), Italy (not authorised), Norway (ongoing, recruiting), Belgium (authorised, recruitment pending), Denmark (ongoing, recruiting).
Therapeutic area(s): Diseases [C] - Neoplasms [C04]; Analytical,Diagnostic,Therapeutic Techniques and Equipment [E]-Surgical Procedures, Operative [E04]
Gender: Female, Male. Age: 18-64 years, 65+ years. Enrolment: 460.
Start date (EU): 2025-08-21. Decision date: 2025-07-23. Results received: No. Last updated: 2026-04-20.
Decision dates by country: FI: 2025-07-28, IT: 2025-10-29, SE: 2025-09-02, NO: 2025-09-05, BE: 2026-03-26, DK: 2026-04-20, NL: 2025-07-23

Condition(s): Pancreatic conditions requiring pancreaticoduodenectomy, such as pancreatic head carcinoma or intraductal papillary mucinous neoplasms (IPMN).
Product: Octreotide Lyomark 0,1 mg/ml oplossing voor injectie, Solu-Cortef, poeder voor injectievloeistof, 100 mg

Primary endpoint: Rate of Major Complications, defined as a Clavien-Dindo score of ≥III and/or postoperative abdominal drain placement
Endpoint(s): Rate of postoperative pancreatic fistula (POPF)* grade B/C. as defined by the international studygroup for pancreatic surgery (ISGPS), Rate of delayed gastric emptying (DGE) according to the ISGPS definition, Rate of post pancreatectomy hemorrhage (PPH) according to the ISGPS definition, Rate of chyle leakage (CL) according to the ISGPS definition, Rate of bile leakage (BL) according to the ISGPS definition, Rate of post-pancreatectomy acute pancreatitis (PPAP), Reintervention during admission/re-admission (either radiological, surgical or endoscopic), Adverse drug reactions to hydrocortisone and octreotide, Multi-organ failure during admission/re-admission, ICU admission, Time to functional recovery, Length of hospital stay in days during admission/re-admission, Readmission within 90 days after surgery, In-hospital and 90-day mortality

Source: https://euclinicaltrials.eu/ctis-public/view/2024-519667-18-00